EU clinical trial 2024-514222-24-00: Randomized, placebo-controlled, double-blind study to evaluate the efficacy of 2LEBV® and 2LXFS® on asthenia in patients with an EBV infection
Sponsor: Labo'Life Belgium (Pharmaceutical company). Phase: Therapeutic use (Phase IV). Countries: Belgium (ongoing, recruiting).
Therapeutic area(s): Diseases [C] - Virus Diseases [C02]
Gender: Female, Male. Age: 0-17 years, 18-64 years. Enrolment: 88.
Status: Ongoing, recruiting. Start date (EU): 2024-06-04. Decision date: 2024-06-03. Results received: No. Last updated: 2024-06-03.

Condition(s): Epstein-Barr Virus infection
Product: Placebo, 2LEBV granules en gélules à ouvrir, 2LXFS

Primary endpoint: The general fatigue scale of the MFI-20 questionnaire at the end of the treatment (6-month visit - V4)
Endpoint(s): - Physical fatigue, reduced activity, reduced motivation and mental fatigue scales on the MFI-20 questionnaire at V4, - 5 scales on the MFI-20 questionnaire at V3 and V5, - Other EBV infection-related symptoms: Long-lasting exhaustion even after light exertion, subfebrile state, fever, loss of appetite, nausea, angina, conjunctivitis, sensitive cervical or axillary lymph nodes, erythematous and swollen tonsil, headaches, sore throat, myalgia, muscular weakness, arthralgia, splenomegaly, visual disorders, memory disorders, attention deficit disorders, sleep disorders, gastrointestinal disorders, breathing disorders, cardiovascular disorders at V3, V4 and V5, - Lymphocytes typing and immune status (normo, hypo or hyperactive immune system) at V1, V3, V4 and V5, - IgG anti-EA, anti-VCA, anti-EBNA and IgM anti-VCA at V0, V1 and V4, - Safety: Occurrence of Adverse Events (AEs) and Severe Adverse Events (SAEs), considered as related or not to the study drug.

Source: https://euclinicaltrials.eu/ctis-public/view/2024-514222-24-00